EU clinical trial 2025-524311-37-00: An open label, balanced, randomized, two-treatment, two-period, two-sequence, single-dose, crossover, bioequivalence study comparing Ponatinib Tablets 15 mg, manufactured by Sun Pharmaceutical Industries Limited, India with Iclusig (Ponatinib hydrochloride) tablets 15 mg, Produced by: Patheon Inc. Mississauga, Canada or Takeda Ireland Limited Bray, Ireland, Imported and registered by: Pint Pharma Medical-Hospital and Pharmaceutical Products Ltd. Nelson Pontes Street, 125, Block 03, Jardim Margarida Zip Code 06739-024, Vargem Grande Paulista – SP CNPJ No. 21,896,000/0001-91, in healthy adult, human subjects under fasting condition.
Protocol code: PONAT-14-25
Sponsor: Sun Pharmaceutical Industries Limited (Pharmaceutical company). Phase: Human Pharmacology (Phase I)- Bioequivalence Study. Countries: Romania (ended).
Therapeutic area(s): Diseases [C] - Neoplasms [C04]
Gender: Male. Age: 18-64 years. Enrolment: 56.
Status: Ended. Start date (EU): 2026-05-19. End date (EU): 2026-07-27. Decision date: 2026-04-20. Results received: No. Last updated: 2026-06-05.

Condition(s): chronic myeloid leukemia, Philadelphia chromosome-positive acute lymphoblastic leukemia

Source: https://euclinicaltrials.eu/ctis-public/view/2025-524311-37-00